EU clinical trial 2024-514065-19-00: PHASE III, DOUBLE-BLIND, RANDOMIZED, CONTROLLED, NON-INFERIORITY, PHASE III CLINICAL TRIAL TO EVALUATE THE EFFICACY OF SALBUTAMOL MONOTHERAPY COMPARED TO SALBUTAMOL PLUS IPRATROPIUM BROMIDE IN THE MANAGEMENT OF MODERATE ACUTE ASTHMATIC EXARCEBATIONS IN CHILDREN IN THE EMERGENCY DEPARTMENT
Sponsor: Fundacion Para La Investigacion Biomedica Hospital Infantil Universitario Nino Jesus (Hospital/Clinic/Other health care facility). Phase: Therapeutic confirmatory (Phase III). Countries: Spain (ongoing, recruiting).
Therapeutic area(s): Analytical, Diagnostic and Therapeutic Techniques and Equipment [E] - Therapeutics [E02]; Diseases [C] - Respiratory Tract Diseases [C08]
Gender: Female, Male. Age: 0-17 years. Enrolment: 476.
Status: Ongoing, recruiting. Start date (EU): 2025-03-27. Decision date: 2024-10-21. Results received: No. Last updated: 2026-05-12.

Condition(s): Acute asthma. Patients with moderate asthma attacks will be included. Asthmatic crisis/exacerbation (AE) is defined as moderate according to Pulmonary Score and SO2
Product: Placebo de ATROALDO 20 mcg/pulsación solución para inhalación en envase a presión, ATROALDO 20 microgramos/pulsación, solución para inhalación en envase a presión

Primary endpoint: The main goal of the study is to determine whether monotherapy with salbutamol in the inhaled bronchodilator treatment of moderate asthma exacerbations in children in the PED is not inferior to the combination of ipratropium bromide (IB) and salbutamol in reducing the rate of admissions. Admission percentage (main variable) is defined as number of children with moderate asthma attacks admitted / number of children with moderate asthma attacks treated in the emergency department.

Source: https://euclinicaltrials.eu/ctis-public/view/2024-514065-19-00